EU clinical trial 2024-513117-12-00: Goal-directed low oxygen concentration during anesthesia compared to fixed oxygen concentration: A single blind, phase IV, randomized controlled multicenter trial
Sponsor: Region Vaesterbotten, Umea University (Hospital/Clinic/Other health care facility, Educational Institution). Phase: Phase III and phase IV (Integrated). Countries: Sweden (ongoing, recruiting).
Therapeutic area(s): Analytical, Diagnostic and Therapeutic Techniques and Equipment [E] - Anesthesia and Analgesia [E03]
Gender: Female, Male. Age: 18-64 years, 65+ years. Enrolment: 200.
Status: Ongoing, recruiting. Start date (EU): 2025-01-16. Decision date: 2024-10-29. Results received: No. Last updated: 2024-10-29.

Condition(s): Surgery under general anesthesia
Product: OXYGEN

Primary endpoint: Arterial oxygen partial pressure (PaO2) measured on postoperative day 2 compared to the day before surgery. Supplemental oxygen will be ceased before the blood sampling, if possible, for 30 minutes or longer.
Endpoint(s): Change in diffusion capacity for carbon monoxide on day 2 and after 3 months compared to the day preceding surgery (=baseline)., Change in vital capacity (VC) on day 2 and after 3 months compared to baseline., Change in PaO2 and PaCO2 on day 1 and after 3 months compared to baseline., Surgical site infections within 30 days of surgery., Postoperative recovery using the Postoperative Recovery Profile at discharge and after 3 months, Hospital length of stay., Effect of background variables on outcomes, including age, sex, height, weight, body mass index (BMI), type of surgery, duration of surgery, and type of anesthesia.

Source: https://euclinicaltrials.eu/ctis-public/view/2024-513117-12-00